EU clinical trial 2024-516364-28-00: A follow-up trial to assess the persistence of the immune response to the Group B Streptococcus vaccine (GBS‑NN/NN2) after a primary vaccination of healthy pregnant women, and to assess safety, reactogenicity and immunogenicity of the GBS‑NN/NN2 vaccine when administered during the follow-up as a 1 booster dose during a new pregnancy
Protocol code: MVX008
Sponsor: Minervax ApS (Pharmaceutical company). Phase: Phase II and Phase III (Integrated). Countries: Denmark (ongoing, recruitment ended).
Therapeutic area(s): Diseases [C] - Bacterial Infections and Mycoses [C01]
Gender: Female. Age: 0-17 years, 18-64 years. Enrolment: 52.
Status: Ongoing, recruitment ended. Start date (EU): 2025-03-07. Decision date: 2024-12-06. Results received: No. Last updated: 2026-07-01.

Condition(s): Prevention of Group B streptoccoccus infection
Product: GBS-NN/NN2

Primary endpoint: Concentrations of IgG antibodies specific to the AlpN proteins in μg/mL, m easured once a year in all participants
Endpoint(s): 1. In the pregnant participants who received a booster dose of the GBS-NN/NN2 vaccine: Concentrations of IgG antibodies specific to the AlpN proteins in μg/mL pre-dose, at 1 month post-dose, a t delivery, and 6 months after delivery, 2. In pregnant participants who received a booster dose of the GBS-NN/NN2 vaccine and their infant: The ratios of antibody concentrations (IgG) between maternal and cord blood at delivery/birth, 3. In the pregnant participants who did not receive a booster dose of the GBS-NN/NN2 vaccine: Concentrations of IgG antibodies specific to the AlpN proteins in μg/mL at delivery, 4. In pregnant participants who did not receive a booster dose of the GBS-NN/NN2 vaccine and their infant: The ratios of antibody concentrations (IgG) between maternal and cord blood at delivery/birth, 5. In the infants born to participants who received a booster dose of the GBS-NN/NN2 vaccine: Concentrations of IgG antibodies specific to the AlpN proteins in μg/mL in cord blood and at 1 month and 3 months of age, 6. In the infants born to participants who did not receive a booster dose of the GBS-NN/NN2 vaccine: Concentrations of IgG antibodies specific to the AlpN proteins in μg/mL in cord blood, 7. In all participants: Any trial procedure-related SAEs (ie, SAEs related to blood sampling) during the entire trial period, 8. In the pregnant participants who received a booster dose of the GBS-NN/NN2 vaccine: Proportion of participants with solicited local and systemic AEs within 7 days after dosing (ie, day of dosing +6 days post-dose), 9. In the pregnant participants who received a booster dose of the GBS-NN/NN2 vaccine: Proportion of participants with unsolicited AEs within 28 days after dosing (ie, the day of dosing +27 days post-dose), 10. In the pregnant participants who received a booster dose of the GBS-NN/NN2 vaccine: Proportion of participants with SAEs up to 6 months after delivery, 11. In the pregnant participants who received a booster dose of the GBS-NN/NN2 vaccine: Proportion of participants with AESIs up to delivery, 12. In the infants born to participants who received a booster dose of the GBS-NN/NN2 vaccine: GA, weight, length, head circumference, and Apgar score, 13. In the infants born to participants who received a booster dose of the GBS-NN/NN2 vaccine: Proportion of infant participants with unsolicited AEs up to 1 month of age, 14. In the infants born to participants who received a booster dose of the GBS-NN/NN2 vaccine:Proportion of infant participants with MAAEs, SAEs, and AESIs up to 6 months of age, 15. In pregnant participants who received a booster dose of the GBS-NN/NN2 vaccine and their infant: OPkA titres in maternal blood at 1 month post-dose and at delivery, 16. In pregnant participants who received a booster dose of the GBS-NN/NN2 vaccine and their infant: PkA titres in infant participants cord blood and at 1 month and 3 months of age

Source: https://euclinicaltrials.eu/ctis-public/view/2024-516364-28-00